EU clinical trial 2025-521660-35-00: A Phase 3, Multicenter, Randomized, Double-Blind, Placebo-Controlled Trial to Evaluate the Efficacy and Safety of Navenibart in Participants with Hereditary Angioedema - ALPHA-ORBIT
Protocol code: STAR-0215-301
Sponsor: Astria Therapeutics Inc. (Pharmaceutical company). Phase: Therapeutic confirmatory (Phase III). Countries: Spain (ongoing, recruitment ended), Germany (ended), Bulgaria (ended), France (ongoing, recruitment ended), Hungary (ongoing, recruitment ended), Austria (ongoing, recruitment ended), Poland (ongoing, recruitment ended), Italy (ongoing, recruitment ended), Czechia (ongoing, recruitment ended), Netherlands (ended), Portugal (ongoing, recruitment ended).
Therapeutic area(s): Diseases [C] - Congenital, Hereditary, and Neonatal Diseases and Abnormalities [C16]
Gender: Female, Male. Age: 0-17 years, 18-64 years, 65+ years. Enrolment: 53.
Start date (EU): 2025-09-11. Decision date: 2025-08-18. Results received: No. Last updated: 2026-06-30.
Decision dates by country: PT: 2025-08-19, AT: 2025-08-22, HU: 2025-08-21, ES: 2025-08-20, NL: 2025-08-18, CZ: 2025-08-20, PL: 2025-08-22, DE: 2025-08-20, IT: 2025-09-17, FR: 2025-08-19, BG: 2025-08-21

Condition(s): Hereditary Angioedema
Product: Navenibart - matching placebo, Navenibart

Primary endpoint: Number of time-normalized investigator-confirmed HAE attacks during the 6-month Treatment Period.
Endpoint(s): Number of moderate or severe investigator-confirmed HAE attacks during the 6-month Treatment Period., Number of investigator-confirmed HAE attacks that require on-demand treatment during the 6-month Treatment Period., Percent reduction in monthly investigator-confirmed HAE attacks in the 6-month Treatment Period versus the Run-In Period., Time to first investigator-confirmed HAE attack after first and second dose, The number of participants responding to treatment, defined as a ≥ 50%, ≥ 70%, or ≥ 90% reduction from the Run-In Period in investigator‑confirmed HAE attack rate (for adult participants: compared to placebo during the 6-month Treatment Period)., Number of participants with no investigator-confirmed HAE attacks during the 6-month Treatment Period, Change from baseline (Day 1) in the Angioedema Quality of Life questionnaire total score., Other Pre-specified Outcome Measures: Incidence of treatment‑emergent adverse events.

Source: https://euclinicaltrials.eu/ctis-public/view/2025-521660-35-00